EU clinical trial 2024-514169-21-00: A Study to Learn how Various Tablets of the Study Medicine Called Vepdegestrant are Taken up into the Blood in Healthy Adults
Protocol code: C4891038
Sponsor: Pfizer Inc. (Pharmaceutical company). Phase: Human Pharmacology (Phase I)- Other. Countries: Belgium (ended).
Therapeutic area(s): Diseases [C] - Neoplasms [C04]
Gender: Female, Male. Age: 18-64 years, 65+ years. Enrolment: 12.
Status: Ended. Start date (EU): 2024-10-11. End date (EU): 2025-03-14. End date: 2025-03-15. Decision date: 2024-10-08. Results received: No. Last updated: 2025-01-08.

Condition(s): ER+/HER2- Breast Cancer

Source: https://euclinicaltrials.eu/ctis-public/view/2024-514169-21-00